EU clinical trial 2023-509192-16-00: A study to Assess the Effect of Vonafexor on Kidney Function in Subjects With Impaired Renal Function and Suspected MASH
Protocol code: EYP001-210
Sponsor: ENYO Pharma (Pharmaceutical company). Phase: Therapeutic exploratory (Phase II). Countries: Germany (ended).
Therapeutic area(s): Diseases [C] - Nutritional and Metabolic Diseases [C18]
Gender: Female, Male. Age: 18-64 years, 65+ years. Enrolment: 50.
Status: Ended. Start date (EU): 2025-07-01. End date (EU): 2026-03-13. Decision date: 2024-03-14. Results received: No. Last updated: 2026-07-15.

Condition(s): Impaired renal function and suspected MASH
Product: Vonafexor, Vonafexor, ROSUVASTATIN, IOHEXOL

Primary endpoint: Change from baseline of mGFRiohexol and eGFRcreat at W16
Endpoint(s): Plasma concentrations pre-dose (0h) and post-dose (2h, 5h, and 7h) on Day 1 (W0) and D113 (W16), which will be modelled against the MASH PopPK expected values., Change from baseline mGFRiohexol off treatment at W24., Change from baseline of eGFRcreat on treatment at W4, W8, W12 and off treatment at W20, W24 and W28, Correlation of mGFRiohexol with eGFRcreat at baseline, on treatment at W16 and off treatment at W24, Levels and change in albuminuria (Urinary Albumin to Creatinine Ratio (UACR) and proteinuria (Urinary Protein to Creatinine ratio (UPCR)) in morning urine samples at baseline, on treatment at W4, W8, W12, W16 with off treatment at W20, W24 and W28., AEs, SAEs, Changes from baseline at W16 in laboratory safety parameters, physical examination, vital signs and ECGs

Source: https://euclinicaltrials.eu/ctis-public/view/2023-509192-16-00